EU clinical trial 2024-517284-23-00: A Phase 3, Multicenter, Randomized, Double-blind, Placebo-controlled Study Evaluating the Efficacy and Safety ofJNJ-77242113 for the Treatment of Biologic-experienced and Biologic-naïve Participants with Active Psoriatic Arthritis
Protocol code: 77242113PSA3002
Sponsor: Janssen Cilag International (Pharmaceutical company). Phase: Therapeutic confirmatory (Phase III). Countries: Czechia (ongoing, recruiting), Germany (ongoing, recruiting), Italy (ongoing, recruiting), Spain (ongoing, recruiting), Denmark (ongoing, recruiting), Bulgaria (ongoing, recruitment ended), Poland (ongoing, recruiting), Hungary (ongoing, recruiting), Romania (ongoing, recruiting).
Therapeutic area(s): Diseases [C] - Immune System Diseases [C20]
Gender: Female, Male. Age: 18-64 years, 65+ years. Enrolment: 401.
Start date (EU): 2025-04-23. Decision date: 2025-04-14. Results received: No. Last updated: 2026-07-22.
Decision dates by country: BG: 2025-04-17, CZ: 2025-04-15, DK: 2025-04-14, DE: 2025-04-16, HU: 2025-04-15, IT: 2025-04-16, RO: 2025-04-22, ES: 2025-04-14, PL: 2025-04-22

Condition(s): Active Psoriatic Arthritis
Product: JNJ-77242113-AAC Placebo tablet, JNJ-77242113

Primary endpoint: The primary endpoint is the American College of Rheumatology (ACR) 20 response at Week 16

Source: https://euclinicaltrials.eu/ctis-public/view/2024-517284-23-00